EU clinical trial 2023-508557-13-00: A study to test how BI 456906 is taken up in the blood of people with and without kidney problems
Protocol code: 1404-0009
Sponsor: Boehringer Ingelheim International GmbH (Pharmaceutical company). Phase: Human Pharmacology (Phase I)- Other. Countries: Germany (ended).
Therapeutic area(s): Diseases [C] - Nutritional and Metabolic Diseases [C18]
Gender: Female, Male. Age: 18-64 years, 65+ years. Enrolment: 54.
Status: Ended. Start date (EU): 2024-05-08. End date (EU): 2025-09-16. Decision date: 2024-02-23. Results received: No. Last updated: 2025-06-04.

Condition(s): Renal impairment (mild, moderate and severe), Healthy

Source: https://euclinicaltrials.eu/ctis-public/view/2023-508557-13-00